EU clinical trial 2022-502873-40-00: An Operationally Seamless Phase 1/2/3 Study Consisting of a Safety and Dose-finding Phase 1/2 and Randomized, Open-label, Active-controlled Phase 3 to Evaluate UX701 AAV Gene Therapy in Adults with Wilson Disease
Protocol code: UX701-CL301
Sponsor: Ultragenyx Pharmaceutical Inc. (Pharmaceutical company). Phase: Phase I and Phase II (Integrated)- First administration to humans. Countries: Portugal (ongoing, recruiting), Spain (ongoing, recruiting), Denmark (authorised, recruitment pending), Germany (not authorised), Italy (authorised, recruitment pending), France (authorised, recruitment pending).
Therapeutic area(s): Diseases [C] - Congenital, Hereditary, and Neonatal Diseases and Abnormalities [C16]
Gender: Female, Male. Age: 18-64 years, 65+ years. Enrolment: 22.
Start date (EU): 2022-06-13. Decision date: 2023-05-16. Results received: No. Last updated: 2026-07-14.
Decision dates by country: ES: 2023-05-16, PT: 2023-05-31, IT: 2024-03-26, FR: 2024-07-01, DK: 2024-03-25

Condition(s): Wilson disease
Product: TACROLIMUS, RITUXIMAB, Prednisolon STADA® 10 mg Tabletten, Prednisolon STADA® 5 mg Tabletten, ECULIZUMAB

Primary endpoint: Stage 1 (Phase 1/2) Primary Endpoints include the following assessments for UX701: Incidence of TEAEs, TESAEs, AESIs, treatment-related TEAEs, and treatment-related TESAEs, Stage 1 (Phase 1/2) Primary Endpoints include the following assessments for UX701: Change in 24-hour urinary copper concentration from Baseline at Week 52, Stage 1 (Phase 1/2) Primary Endpoints include the following assessments for UX701: Change in total copper, ceruloplasmin, NCC, free copper, and ceruloplasmin activity levels from Baseline at Week 52, Stage 1 (Phase 1/2) Primary Endpoints include the following assessments for UX701: Percent reduction in SOC medication by Week 52, Stage 1 (Phase 1/2) Primary Endpoints include the following assessments for UX701: Number of subjects who discontinue SOC medication by Week 52 (measured as complete response, response, or no response), Stage 1 (Phase 1/2) Primary Endpoints include the following assessments for UX701: Number of consecutive weeks off SOC medication at Week 52, Stage 2 (Phase 3):Change in 24-hour urinary copper from Baseline at Week 52, evaluated for superiority, Stage 2 (Phase 3) Primary Endpoints;Percent reduction in SOC medication by Week 52, evaluated for superiority
Endpoint(s): Stage 2 (Phase 3) Secondary Endpoints include the following comparisons between UX701 and placebo: Change in ceruloplasmin activity levels from Baseline at Week 52, evaluated for superiority, Stage 2 (Phase 3) Secondary Endpoints Number of subjects who discontinue SOC medication by Week 52, Stage 2 (Phase 3) Secondary Endpoints Change in FACIT-Fatigue scale score from Baseline at Week 52;Change in liver copper concentration assessed by liver biopsy from Baseline at Week 52

Source: https://euclinicaltrials.eu/ctis-public/view/2022-502873-40-00